EU clinical trial 2023-509747-27-00: C3651011 - A PHASE 2, DOUBLE-BLIND, RANDOMIZED, PLACEBO-CONTROLLED, 4-ARM STUDY TO INVESTIGATE SYMPTOMS, FUNCTION, HEALTH-RELATED QUALITY OF LIFE AND SAFETY WITH REPEATED SUBCUTANEOUS ADMINISTRATION OF PONSEGROMAB VERSUS PLACEBO IN ADULT PARTICIPANTS WITH HEART FAILURE
Protocol code: C3651011
Sponsor: Pfizer Inc. (Pharmaceutical company). Phase: Therapeutic exploratory (Phase II). Countries: Germany (ended), Poland (ended), Hungary (ended), Czechia (ended), Spain (ended).
Therapeutic area(s): Diseases [C] - Cardiovascular Diseases [C14]
Gender: Female, Male. Age: 18-64 years, 65+ years. Enrolment: 155.
Status: Ended. Start date (EU): 2023-05-18. End date (EU): 2024-11-27. End date: 2025-03-05. Decision date: 2024-04-12. Results received: Yes. Last updated: 2024-12-11.
Decision dates by country: DE: 2024-04-16, ES: 2024-04-16, PL: 2024-04-12, HU: 2024-05-23, CZ: 2024-04-12

Condition(s): Heart failure
Product: Ponsegromab (PF-06946860), Placebo for ponsegromab (pf-06946860) solution for injection

Primary endpoint: Change from baseline in KCCQ-23 CSS at Week 22.
Endpoint(s): Main Cohort: • Change from baseline in KCCQ-23 OSS, TSS, and physical limitation at Week 22., Main Cohort: • Responses as defined by a ≥5-point increase from baseline in KCCQ-23 CSS, OSS, TSS, and physical limitation at Week 22., Main Cohort: • Change from baseline in 6MWD at Week 22., Main Cohort: • Change from baseline in PROMIS Fatigue 7a at Week 22., Main Cohort: • Incidence of TEAEs, TESAEs, abnormal laboratory results, and vital signs., Open-Label, PK Cohort: • Incidence of TEAEs, TESAEs, abnormal laboratory results, and vital signs.

Source: https://euclinicaltrials.eu/ctis-public/view/2023-509747-27-00